EU clinical trial 2023-506052-24-00: Ketamine for combined depression and alcohol use disorder: A blinded randomized active placebo-controlled trial (the KeDA trial)
Protocol code: 2022/484848
Sponsor: University Hospital Of North Norway HF (Hospital/Clinic/Other health care facility). Phase: Phase I and Phase II (Integrated)- Other. Countries: Norway (ongoing, recruiting).
Therapeutic area(s): Psychiatry and Psychology [F] - Mental Disorders [F03]; Analytical, Diagnostic and Therapeutic Techniques and Equipment [E] - Therapeutics [E02]; Not possible to specify
Gender: Female, Male. Age: 18-64 years. Enrolment: 34.
Status: Ongoing, recruiting. Start date (EU): 2025-01-20. Decision date: 2024-02-23. Results received: No. Last updated: 2026-07-17.

Condition(s): Depression, Alcohol use disorder
Product: Ketalar 50 mg/ml injeksjonsvæske, oppløsning, Midazolam Accord 1 mg/ml, injeksjonsvæske/infusjonsvæske, oppløsning

Primary endpoint: The primary outcome is the difference in the change in MADRS from baseline to within three days from the final treatment session between intervention group and control group
Endpoint(s): Assess group differences in the change in alcohol craving from baseline, Assess changes in alcohol consumption (measured by average number of alcohol units per week and percentage of days abstinent) from three months prior to admission until six-months post-treatment, Assess frequency, severity and duration of ARs/SARs, Assess and compare between groups tolerability for each treatment session (participant- and physician-reported tolerability), Assess within- and between-group changes in neurocognitive function from baseline to within three days from the final treatment session

Source: https://euclinicaltrials.eu/ctis-public/view/2023-506052-24-00